EU clinical trial 2024-510947-71-00: A phase IIIb, multi-center, open-label, randomized study of tolerability and efficacy of oral asciminib versus nilotinib in patients with newly diagnosed Philadelphia Chromosome Positive Chronic Myelogenous Leukemia in Chronic Phase
Protocol code: CABL001J12302
Sponsor: Novartis Pharma AG (Pharmaceutical company). Phase: Therapeutic confirmatory (Phase III). Countries: Germany (ongoing, recruitment ended), Slovakia (ongoing, recruitment ended), Hungary (ongoing, recruitment ended), Italy (ongoing, recruitment ended), Czechia (ongoing, recruitment ended), Bulgaria (ongoing, recruitment ended), France (ongoing, recruitment ended), Romania (ongoing, recruitment ended), Greece (ongoing, recruitment ended), Netherlands (ongoing, recruitment ended).
Therapeutic area(s): Diseases [C] - Neoplasms [C04]; Diseases [C] - Hemic and Lymphatic Diseases [C15]
Gender: Female, Male. Age: 18-64 years, 65+ years. Enrolment: 389.
Status: Ongoing, recruitment ended. Start date (EU): 2022-11-21. Decision date: 2024-06-19. Results received: No. Last updated: 2026-07-27.
Decision dates by country: FR: 2024-06-27, CZ: 2024-06-20, NL: 2024-06-19, RO: 2024-07-02, BG: 2024-08-02, HU: 2024-06-20, SK: 2024-06-24, GR: 2024-07-22, IT: 2024-07-01, DE: 2024-06-25

Condition(s): Chronic Myeloid Leukemia
Product: ASCIMINIB HYDROCHLORIDE, NILOTINIB, NILOTINIB, NILOTINIB

Primary endpoint: Time to discontinuation of study treatment due to adverse event (TTDAE). TTDAE is defined as the time from the date of first dose of study treatment to the date of discontinuation of study treatment due to adverse event (AE).
Endpoint(s): Secondary endpoint on efficacy: •MMR at and by all scheduled time points •MR4.0 and MR4.5 at and by all scheduled time points •Complete Hematological Response at and by all scheduled time points •BCR::ABL1 ≤1% at and by all scheduled time points •Duration of MMR, MR4.0, MR4.5 •Time to first MMR, first MR4.0, first MR4.5 •Time to treatment failure •Event Free Survival •Progression free survival •Overall survival •TTD due to selected reasons, Secondary endpoint on PRO: Change from baseline in overall scores and individual scales of the EORTC QLQ-C30, EORTC QLQ-CML24., Secondary endpoint on safety: Type, frequency and severity of adverse events, dose modification due to adverse event, changes in laboratory values that fall outside the pre-determined ranges and clinically notable ECG changes, and other safety data (vital signs, physical examination).

Source: https://euclinicaltrials.eu/ctis-public/view/2024-510947-71-00